EU clinical trial 2023-507882-24-00: A study in healthy subjects investigating the safety, tolerability and concentrations of FE 999301 after single and multiple doses
Protocol code: 000414
Sponsor: Ferring Pharmaceuticals A/S (Pharmaceutical company). Phase: Human Pharmacology (Phase I)- First administration to humans. Countries: Germany (ended).
Therapeutic area(s): Diseases [C] - Immune System Diseases [C20]
Gender: Male. Age: 18-64 years. Enrolment: 48.
Status: Ended. Start date (EU): 2024-02-20. End date (EU): 2024-11-15. Decision date: 2024-02-08. Results received: No. Last updated: 2024-02-08.

Condition(s): Inflammatory Gastrointestinal Disease

Source: https://euclinicaltrials.eu/ctis-public/view/2023-507882-24-00